EU clinical trial 2024-511781-37-00: A multicenter, open label, randomized phase II study comparing daratumumab combined with bortezomib-cyclophosphamide-dexamethasone (Dara-VCd) versus the association of bortezomib-thalidomide-dexamethasone (VTd) as pre transplant induction and post transplant consolidation, both followed by a maintenance phase with ixazomib alone or in combination with daratumumab, in newly diagnosed multiple myeloma (MM) young patients eligible for autologous stem cell transplantation
Protocol code: EMN18
Sponsor: European Myeloma Network B.V., Emn Trial Office S.r.l. Impresa Sociale, Ceska Myelomova Skupina z.s. (Patient organisation/association, Laboratory/Research/Testing facility, Patient organisation/association). Phase: Therapeutic exploratory (Phase II). Countries: Greece (ongoing, recruitment ended), Czechia (ongoing, recruitment ended), Italy (ongoing, recruitment ended).
Therapeutic area(s): Diseases [C] - Neoplasms [C04]
Gender: Female, Male. Age: 18-64 years. Enrolment: 401.
Status: Ongoing, recruitment ended. Start date (EU): 2019-04-16. Decision date: 2024-06-28. Results received: No. Last updated: 2026-07-28.
Decision dates by country: GR: 2024-08-28, CZ: 2024-06-28, IT: 2024-07-23

Condition(s): YOUNG PATIENTS AFFECTED BY MULTIPLE MYELOMA (MM) TO THE DIAGNOSIS ELIGIBLE TO THE AUTOLOGOUS TRANSMISSION OF STEM CELLS
Product: Dexamethasone Krka 40 mg tablety, Endoxan Baxter 50 mg Compresse rivestite, Endoxan 50 mg obalené tablety, SOLDESAM 8 mg/2 ml soluzione iniettabile, DARZALEX 1800 mg solution for injection, Dexamethasone Krka 20 mg tablety, SOLDESAM 0,2% gocce orali, soluzione, Thalidomide BMS 50 mg hard capsules, Endoxan 500 mg prášek pro injekční/infuzní roztok, Endoxan Baxter 500 mg Polvere per soluzione iniettabile, VELCADE 3.5 mg powder for solution for injection, DEXAMETHASONE/ROSEMONT 2 mg/5 ml Πόσιμο Διάλυμα, Endoxan® - Επικαλυμμένο δισκίο, Endoxan Baxter 200 mg Polvere per soluzione iniettabile

Primary endpoint: Progression free survival (PFS): PFS in part 1 and part 2 of the study will be measured from the date of first or second randomization to the date of first observation of disease progression or death to any cause as an event. In the first part the efficacy of Dara VCd will be compared with VTd at 3 years from the first randomization; in the second part the efficacy of daratumumab-ixazomib will be compared with ixazomib at 2 years from the second randomization., MRD negativity: MRD evaluation by clonotypic analysis of immunoglobulin heavy chain (IgH) VDJ gene rearrangement will be performed on bone marrow samples obtained by the end of induction and consolidation therapy and thereafter every 6 months after the first maintenance treatment dose. For this purpose, the ClonoSEQ TM assay (Adaptive Biotechnologies, Seattle) will be used at sensitivity thresholds of 10 -3 (1 cancer cell per 1,000 nucleated cells), 10 -4 and ≥10 –5 .
Endpoint(s): Overall response rate (ORR): ORR will include at least PR using the International Response Criteria reported by Durie et al. Categories of response will include stringent Complete Response (sCR), CR, VGPR, PR, SD and PD. If, during the course of the study, other relevant categories are identified in the literature, then these categories may be added. Responders are defined as subjects with at least a PR., Progression free survival 2 (PFS2): PFS2 will be measured from the date of first randomization to the date of observation of second disease progression (i.e. progression after the second line of therapy) or death to any cause as an event., Duration of response (DoR): Time between first documentation of response and PD., Overall survival (OS): OS is defined as the time between the date of first randomization and death., Time to progression (TTP): TTP will be measured from the date of randomization to the date of first observation of PD, or deaths due to PD., Time to the next anti-myeloma therapy (TNT): TNT will be measured from the date of first randomization to the date of next anti-myeloma therapy., MRD by NGF and PET/CT ✓ Immunophenotypic CR is defined as CR plus absence of phenotypically aberrant PCs (clonal) in bone marrow with a minimum of 1 million total bone marrow cells analyzed by multiparametric flow cytometry (with 2 tubes of 8 colors) ✓ PET/CT negativity is defined as the complete disappearance of any area of FDG uptake, according to the IMWG criteria., Definition of prognostic factors, as assessed by NGS (MM-panel): NGS will be employed to deeply characterize MM CD138+ clone(s) both at diagnosis and at time of first progression. NGS data will be analyzed to describe patients genomic profile at baseline and to identify prognostic factors related to disease progression. A stratification of patients will be performed according to the evolution patterns, and eventual clinical correlations will be searched.

Source: https://euclinicaltrials.eu/ctis-public/view/2024-511781-37-00